EU clinical trial 2024-516940-24-00: CHemotherapy And Sequential ImmunoTherapy for locally advanced urothelial cancer: the CHASIT study
Protocol code: CHASIT
Sponsor: Erasmus Universitair Medisch Centrum Rotterdam (Erasmus MC) (Hospital/Clinic/Other health care facility). Phase: Therapeutic exploratory (Phase II). Countries: Netherlands (ongoing, recruiting).
Therapeutic area(s): Diseases [C] - Male Urogenital Diseases [C12]; Diseases [C] - Female Urogenital Diseases and Pregnancy Complications [C13]
Gender: Female, Male. Age: 18-64 years, 65+ years. Enrolment: 58.
Status: Ongoing, recruiting. Start date (EU): 2024-10-29. Decision date: 2024-10-29. Results received: No. Last updated: 2025-11-05.

Condition(s): locally advanced urothelial cancer.
Product: Bavencio 20 mg/mL concentrate for solution for infusion

Primary endpoint: Pathological complete response rate, defined as the proportion of patients without residual UC in the surgical resection specimen, ypT0N0 (carcinoma situ is allowed), in the intention-to-treat analysis.
Endpoint(s): Progression-free, cancer-specific and overall survival at 24 months, calculated from the time of 1st administration of avelumab., Safety and tolerability of preoperative avelumab as assessed by the CTCAE v5.0 (Appendix 9)., Clavien-Dindo surgical complications (within 30 and 90 days from date of surgery) (Appendix 10)., The rate of non-invasive urothelial cancer in the surgical resection specimen, stage ypT0N0/ypTisN0/ypTaN0/ypT1N0., The proportion of patients in whom radical surgery is delayed >8 weeks after last administration of avelumab due to toxicity.

Source: https://euclinicaltrials.eu/ctis-public/view/2024-516940-24-00